EU clinical trial 2024-513848-28-00: A Single Dose, Non-randomised, Open-label, Parallel Group Study to Assess the Pharmacokinetics, Safety, and Tolerability of AZD4144 in Participants with Severe Renal Impairment, End-stage Kidney Disease, and in Healthy Participants
Protocol code: D9440C00003
Sponsor: AstraZeneca AB (Pharmaceutical company). Phase: Human Pharmacology (Phase I)- Other. Countries: Bulgaria (ended), Romania (ended).
Therapeutic area(s): Not possible to specify
Gender: Female, Male. Age: 18-64 years, 65+ years. Enrolment: 33.
Status: Ended. Start date (EU): 2024-11-11. End date (EU): 2025-04-23. Decision date: 2024-10-28. Results received: No. Last updated: 2025-03-10.
Decision dates by country: BG: 2024-10-28, RO: 2024-11-07

Condition(s): Healthy Volunteers, Renal Impairment and End Stage Kidney Disease

Source: https://euclinicaltrials.eu/ctis-public/view/2024-513848-28-00